EU clinical trial 2023-505678-14-00: A Multicenter, Randomized Study to Evaluate the Safety and Efficacy of Lutikizumab for Induction and Maintenance Therapy in Subjects with Moderately to Severely Active Ulcerative Colitis
Protocol code: M23-703
Sponsor: AbbVie Deutschland GmbH & Co. KG (Pharmaceutical company). Phase: Therapeutic exploratory (Phase II). Countries: Austria (ended), Poland (ongoing, recruitment ended), Croatia (ongoing, recruitment ended), Netherlands (not authorised), Germany (ended), Greece (ongoing, recruitment ended), Bulgaria (ended), Norway (ended), Spain (ongoing, recruitment ended), Belgium (ended), Latvia (ended), Italy (ended), Slovenia (ended), France (ended), Estonia (ended), Hungary (ended), Ireland (ended), Lithuania (ongoing, recruitment ended).
Therapeutic area(s): Diseases [C] - Digestive System Diseases [C06]
Gender: Female, Male. Age: 18-64 years, 65+ years. Enrolment: 96.
Start date (EU): 2024-08-19. Decision date: 2024-07-23. Results received: No. Last updated: 2026-06-09.
Decision dates by country: NL: 2024-07-23, BE: 2024-07-23, BG: 2024-09-13, AT: 2024-07-29, IT: 2024-07-24, IE: 2024-07-26, FR: 2024-07-25, SI: 2024-07-23, LV: 2024-08-07, NO: 2024-07-23, DE: 2024-07-26, ES: 2024-07-24, LT: 2024-08-07, PL: 2024-07-29, HU: 2024-07-24, HR: 2024-07-26, EE: 2024-07-25, GR: 2024-07-24

Condition(s): Ulcerative Colitis
Product: Humira 40 mg solution for injection in pre-filled syringe, Lutikizumab, Humira 40 mg solution for injection in pre-filled syringe, Lutikizumab, Humira 80 mg solution for injection in pre-filled syringe, Humira 40 mg solution for injection in pre-filled syringe, Humira 40 mg solution for injection in pre-filled syringe

Primary endpoint: Percentage of Participants who Achieve Endoscopic Improvement at week 12
Endpoint(s): Percentage of Participants who Achieve Clinical Remission Per Modified Mayo Score (mMS) at week 12, Percentage of Participants who Achieve Clinical Response Per mMS at week 12, Percentage of Participants who Achieve Endoscopic Remission at week 12

Source: https://euclinicaltrials.eu/ctis-public/view/2023-505678-14-00